EU clinical trial 2023-508963-58-00: A Follow-Up, Open Label, Research Evaluation of Sustained Treatment with Aficamten (CK-3773274) in Hypertrophic Cardiomyopathy (HCM)
Protocol code: CY 6022
Sponsor: Cytokinetics Inc. (Pharmaceutical company). Phase: Therapeutic exploratory (Phase II). Countries: Netherlands (ongoing, recruiting), Poland (ongoing, recruiting), Portugal (ongoing, recruiting), France (ongoing, recruiting), Denmark (ongoing, recruiting), Germany (ongoing, recruiting), Italy (ongoing, recruiting), Hungary (ongoing, recruiting), Spain (ongoing, recruiting), Czechia (ongoing, recruiting), Greece (ongoing, recruiting), Iceland (ongoing, recruiting).
Therapeutic area(s): Diseases [C] - Cardiovascular Diseases [C14]
Gender: Female, Male. Age: 18-64 years, 65+ years. Enrolment: 222.
Status: Ongoing, recruiting. Start date (EU): 2022-01-31. Decision date: 2024-06-28. Results received: No. Last updated: 2026-04-29.
Decision dates by country: HU: 2024-06-28, IS: 2025-08-14, PL: 2024-07-02, IT: 2024-07-03, FR: 2024-06-28, NL: 2024-06-28, PT: 2024-06-28, DK: 2024-06-28, CZ: 2024-07-03, ES: 2024-07-03, DE: 2024-07-01, GR: 2025-08-12

Condition(s): Symptomatic hypertrophic cardiomyopathy (HCM)
Product: Aficamten, Aficamten, Aficamten, Aficamten

Primary endpoint: 1. Patient incidence of reported adverse events (AEs), 2. Patient incidence of reported serious adverse events (SAEs), 3. Patient incidence of left ventricular ejection fraction (LVEF) <50%
Endpoint(s): 1. Change from baseline values through end of participation in: − Peak LVOT-G at rest and with Valsalva provocation − Proportion of patients with resting LVOT-G <30 mmHg − Proportion of patients with post-Valsalva LVOT-G <50 mmHg − Proportion of patients with post-Valsalva LVOT-G <30 mmHg − Proportion of patients with LVEF ≥50%, resting LVOT-G <30 mmHg, and post-Valsalva LVOT-G <50 mmHg, 2. Time to the following event through last follow-up - First resting LVOT-G <30 mmHg − First post-Valsalva LVOT-G <50 mmHg − First post-Valsalva LVOT-G <30 mmHg − First LVEF ≥50%, resting LVOT-G <30 mmHg, and post-Valsalva LVOT-G <50 mmHg

Source: https://euclinicaltrials.eu/ctis-public/view/2023-508963-58-00